EU clinical trial 2024-515089-15-00: A Phase 3 Randomized, Double-Masked, Placebo-Controlled Study to Investigate the Safety and Efficacy of Oral Brepocitinib in Adults with Active, Non-Infectious Intermediate-, Posterior-, and Panuveitis
Protocol code: PVT-2201-303
Sponsor: Priovant Therapeutics Inc. (Pharmaceutical company). Phase: Therapeutic confirmatory (Phase III). Countries: Hungary (ongoing, recruitment ended), Spain (ongoing, recruitment ended), Italy (ongoing, recruitment ended), Czechia (ongoing, recruitment ended), Germany (ongoing, recruitment ended), Belgium (ongoing, recruitment ended), Greece (ongoing, recruitment ended), Austria (ongoing, recruitment ended), Poland (ended).
Therapeutic area(s): Diseases [C] - Eye Diseases [C11]
Gender: Female, Male. Age: 18-64 years, 65+ years. Enrolment: 105.
Start date (EU): 2025-02-28. Decision date: 2025-02-25. Results received: No. Last updated: 2026-07-30.
Decision dates by country: PL: 2025-03-02, BE: 2025-03-03, ES: 2025-02-27, CZ: 2025-02-27, DE: 2025-02-25, GR: 2025-02-25, IT: 2025-03-03, HU: 2025-02-27, AT: 2025-02-28

Condition(s): active non-infectious uveitis (intermediate uveitis, posterior uveitis, panuveitis)
Product: Prednison 5 mg GALEN® Tabletten, Prednison 10 mg GALEN®, brepocitinib, Prednison 20 mg GALEN®, Placebo tablet to match 45 mg brepocitinib tablet.

Primary endpoint: Time to treatment failure on or after Period 1 Week 6 up to Period 1 Week 48
Endpoint(s): Proportion of participants meeting treatment failure criteria on or after Period 1 Week 6 up to Period 1 Week 24, Change in logarithm of the minimum angle of resolution (logMAR) best corrected visual acuity (BCVA) in each eye from best state achieved at or prior to Period 1 Week 6 up to Period 1 Week 24;, Change in central subfield thickness from best state achieved in each eye at or prior to Period 1 Week 6 up to Period 1 Week 24, Change in logMAR BCVA in each eye from best state achieved at or prior to Period 1 Week 6 up to Period 1 Week 48, Change in central subfield thickness from best state achieved in each eye at or prior to Period 1 Week 6 up to Period 1 Week 48

Source: https://euclinicaltrials.eu/ctis-public/view/2024-515089-15-00